EU clinical trial 2023-506881-30-00: A Pharmacokinetics (PK) study to compare GME751 (proposed pembrolizumab biosimilar) and United States (US)-licensed and European Union (EU)-approved Keytruda®in participants with stage Ⅱ and Ⅲ skin cancer requiring adjuvant treatment (therapy applied after initial treatment of cancer to suppress the regrowth of tumor) with pembrolizumab.
Protocol code: CGME751A12101
Sponsor: H e x a l AG (Pharmaceutical company). Phase: Human Pharmacology (Phase I)- Other. Countries: Romania (ended), Germany (ended), Italy (ended), Lithuania (ended), France (ended), Spain (ended).
Therapeutic area(s): Diseases [C] - Neoplasms [C04]
Gender: Female, Male. Age: 18-64 years, 65+ years. Enrolment: 136.
Status: Ended. Start date (EU): 2024-05-15. End date (EU): 2026-05-05. End date: 2026-05-06. Decision date: 2024-04-09. Results received: No. Last updated: 2025-11-10.
Decision dates by country: ES: 2024-05-20, IT: 2024-06-03, LT: 2024-04-11, FR: 2024-04-15, RO: 2024-04-15, DE: 2024-04-12

Condition(s): Melanoma

Source: https://euclinicaltrials.eu/ctis-public/view/2023-506881-30-00